EU clinical trial 2024-515404-39-00: A Randomized, placebo-controlled, Phase III Study of (Neo)Adjuvant Atorvastatin Therapy in Patients with Early Breast Cancer
Sponsor: Region Midtjylland (Hospital/Clinic/Other health care facility). Phase: Therapeutic confirmatory (Phase III). Countries: Denmark (ongoing, recruitment ended).
Therapeutic area(s): Diseases [C] - Neoplasms [C04]
Gender: Female. Age: 18-64 years, 65+ years. Enrolment: 3360.
Status: Ongoing, recruitment ended. Start date (EU): 2021-01-14. Decision date: 2024-09-15. Results received: No. Last updated: 2025-06-03.

Condition(s): Breast cancer
Product: Placebo til Atorvastatin TEVA tablet 80 mg, Atorvastatin Teva, filmovertrukne tabletter

Primary endpoint: Invasive disease-free survival (IDFS), defined as the time from randomization until the date of the first occurrence of one of the following events: Ipsilateral invasive breast tumor recurrence, Regional invasive breast cancer recurrence, Distant recurrence, Death attributable to any cause, including breast cancer, non-breast cancer, or unknown cause, Contralateral invasive breast cancer or Second primary non-breast invasive cancer.
Endpoint(s): Pathological response (only neo-adjuvant treated patients), Distant-recurrence free interval defined as time from inclusion to first distant recurrence including associations with first site of recurrence., Recurrence-free interval including associations with first site of recurrence, Overall survival., Overall safety., Cardiac death-free interval. Cardiac death is defined as: Definitive cardiac death due to heart failure, myocardial infarction or documented primary arrhythmia.

Source: https://euclinicaltrials.eu/ctis-public/view/2024-515404-39-00